EU clinical trial 2024-514937-39-00: A Phase 3, Randomized, Double-Blind, Placebo-Controlled, Multicenter Study to Investigate the Efficacy, Safety, and Tolerability of LP352 in the Treatment of Seizures in Children and Adults with Dravet Syndrome
Protocol code: LP352-302
Sponsor: Longboard Pharmaceuticals Inc. (Pharmaceutical company). Phase: Therapeutic confirmatory (Phase III). Countries: Latvia (ongoing, recruiting), Spain (ongoing, recruiting), Portugal (ongoing, recruiting), Germany (ongoing, recruiting), France (ongoing, recruiting), Belgium (ongoing, recruiting), Italy (ongoing, recruiting), Netherlands (ended), Denmark (authorised, recruiting), Finland (authorised, recruiting), Czechia (ended).
Therapeutic area(s): Diseases [C] - Nervous System Diseases [C10]
Gender: Female, Male. Age: 0-17 years, 18-64 years, 65+ years. Enrolment: 117.
Start date (EU): 2025-05-20. Decision date: 2025-04-30. Results received: No. Last updated: 2026-06-05.
Decision dates by country: IT: 2025-05-21, LV: 2025-04-30, BE: 2025-05-06, DE: 2025-04-30, PT: 2025-04-30, ES: 2025-04-30, FR: 2025-05-06, DK: 2026-05-11, FI: 2026-05-12, CZ: 2026-05-18, NL: 2025-06-18

Condition(s): Dravet Syndrome
Product: Bexicaserin, LP352 (bexicaserin) Placebo Oral Solution

Primary endpoint: Frequency percent change in countable motor seizures during Maintenance compared to Baseline
Endpoint(s): Safety laboratory parameters, Physical examination findings, Vital signs, Growth parameters (height and weight), 12-lead Electrocardiogram (ECGs), Columbia-Suicide Severity Rating Scale (C-SSRS) responses, Patient Health Questionnaire-9 (PHQ-9) total score and Question 9 score, 50% responder rate (the percentage of participants with a ≥50% reduction in countable motor seizures) during Maintenance compared to Baseline, Frequency percent change in countable motor seizures during Treatment compared to Baseline

Source: https://euclinicaltrials.eu/ctis-public/view/2024-514937-39-00